EU clinical trial 2024-516633-12-00: A Randomized, Double-blinded, Multicenter, Phase Ⅲ Clinical Study of HLX22 (Recombinant Humanized Anti-HER2 Monoclonal Antibody Injection) in Combination with Trastuzumab and Chemotherapy (XELOX) versus Trastuzumab and Chemotherapy (XELOX) with or without Pembrolizumab for the First Line Treatment of Locally Advanced or Metastatic Gastroesophageal Junction and Gastric Cancer
Protocol code: HLX22-GC-301
Sponsor: Shanghai Henlius Biotech Inc. (Pharmaceutical company). Phase: Therapeutic confirmatory (Phase III). Countries: Poland (ongoing, recruiting), Romania (ongoing, recruiting), Germany (ongoing, recruiting), Spain (ongoing, recruiting), Italy (ongoing, recruiting), Greece (ongoing, recruiting), Portugal (ongoing, recruiting).
Therapeutic area(s): Diseases [C] - Neoplasms [C04]
Gender: Female, Male. Age: 18-64 years, 65+ years. Enrolment: 106.
Status: Ongoing, recruiting. Start date (EU): 2025-06-30. Decision date: 2025-04-22. Results received: No. Last updated: 2026-02-11.
Decision dates by country: RO: 2025-04-22, PT: 2025-08-01, GR: 2025-08-20, DE: 2025-04-22, IT: 2025-04-24, ES: 2025-04-29, PL: 2025-04-29

Condition(s): Locally advanced/ metastatic gastroesophageal junction and gastric cancer
Product: placebo_pembrolizumab, Recombinant Humanized Anti-HER2 Monoclonal Antibody Injection, PEMBROLIZUMAB, placebo_HLX22

Primary endpoint: Progression-free survival (PFS) (assessed by the Blinded Independent Central Review [BICR] per RECIST v1.1)., Overall survival (OS).
Endpoint(s): Progression-free survival (PFS) (assessed by investigator per RECIST v1.1)., Objective response rate (ORR) (assessed by BICR and investigator per RECIST v1.1)., Progression-free survival on next line of therapy (PFS2) (assessed by investigator per RECIST v1.1), Duration of response (DOR) (assessed by BICR and investigator per RECIST v1.1)., Incidence of adverse events (AEs) and serious adverse events (SAEs)., PK: concentration of HLX22 in serum., Immunogenicity evaluation: incidence of anti-drug antibody (ADA) and neutralizing antibody (NAb) of HLX22., Quality of life assessment.

Source: https://euclinicaltrials.eu/ctis-public/view/2024-516633-12-00